EU clinical trial 2023-506821-12-00: A Phase III, Randomized, Open-Label, Multicenter Study Evaluating the Efficacy and Safety of Giredestrant Plus Everolimus Compared with the Physician’s Choice of Endocrine Therapy Plus Everolimus in Patients with Estrogen Receptor-Positive, Her2-Negative, Locally Advanced or Metastatic Breast Cancer
Protocol code: ML43171
Sponsor: Genentech Inc. (Pharmaceutical company). Phase: Therapeutic confirmatory (Phase III). Countries: Germany (ongoing, recruitment ended), Spain (ongoing, recruitment ended), Greece (ongoing, recruitment ended), Italy (ongoing, recruitment ended).
Therapeutic area(s): Diseases [C] - Neoplasms [C04]
Gender: Female, Male. Age: 18-64 years, 65+ years. Enrolment: 59.
Status: Ongoing, recruitment ended. Start date (EU): 2023-10-12. Decision date: 2024-06-06. Results received: No. Last updated: 2026-07-24.
Decision dates by country: GR: 2024-07-22, DE: 2024-06-06, IT: 2024-07-15, ES: 2024-06-07

Condition(s): Estrogen Receptor (ER)-Positive, HER2-Negative, Locally Advanced or Metastatic Breast Cancer previously treated with a CDK4/6 inhibitor and endocrine therapy
Product: Afinitor 5 mg tablets, RO7197597, EVEROLIMUS, MEXABREST 25 mg compresse rivestite con film, Afinitor 2.5 mg tablets, Everolimus Zentiva 10 mg Tabletten, Faslodex 250 mg solution for injection., EVEROLIMUS, EVEROLIMUS, Afinitor 10 mg tablets, EXEMESTANE ACCORD 25 mg, comprimé pelliculé, Everolimus Zentiva 2,5 mg Tabletten, Exemestan STADA® 25 mg Filmtabletten, Afinitor 2.5 mg tablets, Afinitor 10 mg tablets, Afinitor 5 mg tablets, Tamoxifen 20 PCH, tabletten 20 mg, Everolimus Zentiva 5 mg Tabletten

Primary endpoint: 1. PFS in the ESR1m subpopulation determined by the investigator, 2. PFS in the ITT population, determined by the investigator, PFS is defined as the time from randomization to the first occurrence of disease progression or death from any cause (whichever occurs first), as determined by the investigator according to Response Evaluation Criteria in Solid Tumors, version 1.1 (RECIST v1.1)
Endpoint(s): 1. OS after randomization, defined as the time from randomization to death from any cause, 2.ORR, defined as the proportion of patients with a complete response (CR) or partial response (PR) on two consecutive occasions >= 4 weeks apart, as determined by the investigator according to RECIST v1.1, 3.DOR, defined as the time from the first occurrence of a documented objective response to disease progression or death from any cause (whichever occurs first), as determined by the investigator according to RECIST v1.1, 4.CBR, defined as the proportion of patients with stable disease for >= 24 weeks or a CR or PR on two consecutive occasions >= 4 weeks apart, as determined by the investigator according to RECIST v1.1, 5.TTCD in pain severity, defined as the time from randomization to the first documentation of a ≥2-point increase from baseline on the "worst pain" item score from the Brief Pain Inventory-Short Form (BPI-SF) held for two consecutive time points, or a ≥2-point increase followed by death attributable to cancer progression within 28 days from the last assessment, 6.TTCD in pain presence and interference after randomization, defined as the time from randomization to the first documentation of >= 10-point increase in the European Organisation for Research and Treatment of Cancer (EORTC) Quality of Life-Core 30 Questionnaire (QLQ-C30) linearly transformed pain scale score held for two consecutive time points, or a >=10-point increase followed by death attributable to cancer progression within 28 days from the last assessment, 7.TTCD in PF after randomization, defined as the time from randomization to the first documentation of >= 10-point decrease from baseline in the EORTC QLQ-C30 linearly transformed PF scale score held for two consecutive time points, or a >= 10-point decrease followed by death attributable to cancer progression within 28 days from the last assessment, 8.TTCD in RF after randomization, defined as the time from randomization to the first documentation of >= 10-point decrease from baseline in the EORTC QLQ-C30 linearly transformed RF scale score held for two consecutive time points, or a >= 10-point decrease followed by death attributable to cancer progression within 28 days from the last assessment, 9.TTCD in HRQoL after randomization, defined as the time from randomization to the first documentation of >= 10-point decrease from baseline in the EORTC QLQ-C30 linearly transformed GHS/QoL scale score held for two consecutive time points, or a >= 10-point decrease followed by death attributable to cancer progression within 28 days from the last assessment, 10.Incidence and severity of adverse events, with severity determined according to NCI CTCAE v5.0, 11.Change from baseline in targeted vital signs, 12.Change from baseline in targeted clinical laboratory test results, 13. Plasma concentration of giredestrant at specified timepoints

Source: https://euclinicaltrials.eu/ctis-public/view/2023-506821-12-00